EU clinical trial 2025-524172-29-00: A Phase I, open-label, non-randomized study to assess the absorption, distribution, metabolism and excretion (ADME) and pharmacokinetics of LTP001 following a single oral dose of [14C]LTP001 in healthy male participants
Protocol code: CLTP001A12101
Sponsor: Novartis Pharma AG (Pharmaceutical company). Phase: Human Pharmacology (Phase I)- Other. Countries: Netherlands (ended).
Therapeutic area(s): Not possible to specify
Gender: Male. Age: 18-64 years. Enrolment: 6.
Status: Ended. Start date (EU): 2026-03-18. End date (EU): 2026-06-10. Decision date: 2026-03-06. Results received: No. Last updated: 2026-03-06.

Condition(s): Healthy volunteers

Source: https://euclinicaltrials.eu/ctis-public/view/2025-524172-29-00